EU clinical trial 2023-509544-10-00: Phase IIa, sequential cohort, open-label, multi-center clinical trial to evaluate the efficacy, safety, and tolerability of intravenous induction and subcutaneous maintenance treatment with BI 3032950 in patients with moderate to severe ulcerative colitis
Protocol code: 1486-0006
Sponsor: Boehringer Ingelheim International GmbH (Pharmaceutical company). Phase: Therapeutic exploratory (Phase II). Countries: Poland (ongoing, recruitment ended), Belgium (ongoing, recruitment ended), Slovakia (ongoing, recruitment ended), Czechia (ongoing, recruitment ended).
Therapeutic area(s): Diseases [C] - Digestive System Diseases [C06]
Gender: Female, Male. Age: 18-64 years, 65+ years. Enrolment: 94.
Status: Ongoing, recruitment ended. Start date (EU): 2025-01-15. Decision date: 2024-12-09. Results received: No. Last updated: 2026-08-03.
Decision dates by country: PL: 2024-12-16, BE: 2024-12-12, CZ: 2024-12-11, SK: 2024-12-09

Condition(s): ulcerative colitits
Product: BI 3032950

Primary endpoint: Clinical remission as measured by the modified Mayo score (mMS; defined as mMS of 0 to 2, including stool frequency subscore [SFS] of 0 or 1, rectal bleeding subscore [RBS] of 0, and centrally-read endoscopy subscore [ESS] of 0 or 1) at Week 12
Endpoint(s): Endoscopic remission (defined as centrally-read ESS of 0) at Week 12, Clinical response (defined as a decrease from baseline in mMS ≥2 and at least a 30% reduction from baseline, and a decrease in RBS of ≥1 or an absolute RBS of 0 or 1) at Week 12, Endoscopic improvement (defined as centrally-read ESS of 0 or 1) at Week 12, mMS change from baseline at Week 12, SFS of 0 or 1 at Week 12, RBS of 0 at Week 12, Occurrence of treatment-emergent adverse events (AEs) up to Week 12 and up to Week 104

Source: https://euclinicaltrials.eu/ctis-public/view/2023-509544-10-00